EU clinical trial 2023-508008-39-00: A study to assess the pharmacokinetics, and glucodynamics of LY3209590 in participants with type 2 diabetes
Protocol code: I8H-MC-BDDG
Sponsor: Eli Lilly & Co. (Pharmaceutical company). Phase: Human Pharmacology (Phase I)- Other. Countries: Germany (ended).
Therapeutic area(s): Diseases [C] - Nutritional and Metabolic Diseases [C18]
Gender: Female, Male. Age: 18-64 years, 65+ years. Enrolment: 70.
Status: Ended. Start date (EU): 2023-12-05. End date (EU): 2024-07-18. End date: 2024-07-19. Decision date: 2023-12-01. Results received: No. Last updated: 2024-03-22.

Condition(s): Type 2 Diabetes Mellitus

Source: https://euclinicaltrials.eu/ctis-public/view/2023-508008-39-00